EU clinical trial 2024-518820-65-00: "Efficacy and safety of Balanced Analgosedation in Bronchoscopy with Propofol/Pethidine versus Midazolam/Pethidine: a single-centre randomised controlled trial (ABroProMida Study)"
Protocol code: ABroProMida
Sponsor: Azienda Unita' Sanitaria Locale Toscana Sud Est (Hospital/Clinic/Other health care facility). Phase: Therapeutic use (Phase IV). Countries: Italy (not authorised).
Therapeutic area(s): Diseases [C] - Respiratory Tract Diseases [C08]
Gender: Female, Male. Age: 18-64 years, 65+ years. Enrolment: 530.
Status: Not authorised. Decision date: 2025-03-20. Results received: No. Last updated: 2025-03-20.

Condition(s): Bronchoscopic procedure with analgosedation for the diagnosis and management of various respiratory diseases.
Product: PROPOFOL, MIDAZOLAM, PETHIDINE

Primary endpoint: The primary endpoint of our study is to evaluate and compare the desaturation index (SpO2 < 90% for at least 30 seconds) between the two drug regimens (Propofol+Petidine vs Midazolam+Petidine)..
Endpoint(s): Adverse events (AEs); Procedural Tolerance using scores like the Aldrete score; Serious Adverse Events (SAE); Procedure Time; Final diagnostic yield.

Source: https://euclinicaltrials.eu/ctis-public/view/2024-518820-65-00